EU clinical trial 2023-510019-20-00: A 52-week, randomized, double-blind, double-dummy, parallel-group, multi-centre, non-inferiority study to investigate the efficacy and safety of depemokimab compared with mepolizumab in adults with relapsing or refractory Eosinophilic Granulomatosis with Polyangiitis (EGPA) receiving standard of care (SoC) therapy
Protocol code: 217102
Sponsor: Glaxosmithkline Research & Development Limited (Pharmaceutical company). Phase: Therapeutic confirmatory (Phase III). Countries: Belgium (ended), Spain (ended), Netherlands (ended), Sweden (ended), France (ended), Hungary (ended), Portugal (ended), Italy (ongoing, recruitment ended), Poland (ended), Germany (ended), Austria (ended).
Therapeutic area(s): Diseases [C] - Immune System Diseases [C20]
Gender: Female, Male. Age: 18-64 years, 65+ years. Enrolment: 80.
Start date (EU): 2022-07-13. Decision date: 2024-06-13. Results received: No. Last updated: 2026-05-26.
Decision dates by country: HU: 2024-06-13, BE: 2024-06-14, PL: 2024-07-22, SE: 2024-06-14, PT: 2024-06-19, DE: 2024-06-18, ES: 2024-06-13, NL: 2024-06-14, FR: 2024-06-17, AT: 2024-07-29, IT: 2024-06-18

Condition(s): Relapsing or refractory Eosinophilic Granulomatosis with Polyangiitis (EGPA) receiving standard of care (SoC) therapy
Product: Placebo for Mepolizumab Injection, Placebo for Depemokimab Injection, MEPOLIZUMAB

Primary endpoint: Remission (i.e., a Birmingham Vasculitis Activity Score (BVAS)=0 and a dose of oral corticosteroids (OCS) ≤4mg/day) at both Week 36 and Week 52.
Endpoint(s): Total accrued duration of remission, i.e., the accrued number of weeks where BVAS=0 plus OCS dose ≤4 mg /day over the 52-week intervention period categorised as zero weeks; >0 to <12 weeks; 12 to <24 weeks; 24 to <36 weeks or ≥36 weeks., Total accrued duration of remission, i.e., the accrued number of weeks where BVAS=0 plus OCS dose ≤4 mg /day over the 52-week intervention period., Time to first EGPA relapse., Mean OCS dose during the last 4 weeks of the study treatment period (Weeks 49 to 52) categorised as 0, >0 to ≤4, >4 to ≤7.5 or >7.5 mg/day., Remission (BVAS=0 and OCS ≤4mg/day) within the first 24 weeks with continued remission until Week 52., Remission using the European League against Rheumatism (EULAR) definition; BVAS=0 and OCS ≤7.5 mg/day at both Week 36 and Week 52., Total accrued duration of remission according to the EULAR definition of remission, i.e., the accrued number of weeks where BVAS=0 plus OCS≤7.5 mg/day over the 52-week intervention period categorised as zero weeks; >0 to <12 weeks; 12 to <24 weeks; 24 to <36 weeks or ≥36 weeks., Total accrued duration of remission according to the EULAR definition of remission, i.e., the accrued number of weeks where BVAS=0 plus OCS ≤7.5 mg/day over the 52-week intervention period., Remission (BVAS=0 and OCS ≤7.5 mg/day) within the first 24 weeks with continued remission until Week 52.

Source: https://euclinicaltrials.eu/ctis-public/view/2023-510019-20-00